EU clinical trial 2023-508055-40-00: Weight Maintenance in Adolescents With Obesity; Long-Term Treatment With Semaglutide s.c. 2.4 mg Once-weekly
Protocol code: NN9536-7752
Sponsor: Novo Nordisk A/S (Pharmaceutical company). Phase: Therapeutic use (Phase IV). Countries: Germany (ongoing, recruitment ended), Poland (ongoing, recruitment ended), Denmark (ongoing, recruitment ended), Italy (ongoing, recruitment ended), France (ongoing, recruitment ended), Greece (ongoing, recruitment ended), Sweden (ongoing, recruitment ended), Belgium (ongoing, recruitment ended).
Therapeutic area(s): Diseases [C] - Nutritional and Metabolic Diseases [C18]
Gender: Female, Male. Age: 0-17 years. Enrolment: 309.
Status: Ongoing, recruitment ended. Start date (EU): 2025-02-18. Decision date: 2025-02-10. Results received: No. Last updated: 2026-07-24.
Decision dates by country: BE: 2025-02-11, DK: 2025-02-10, FR: 2025-02-12, DE: 2025-02-13, GR: 2025-02-11, IT: 2025-02-11, SE: 2025-02-12, PL: 2025-02-17

Condition(s): Obesity
Product: Wegovy 1.7 mg FlexTouch solution for injection in pre-filled pen, Wegovy 1 mg FlexTouch solution for injection in pre-filled pen, Wegovy 0.25 mg FlexTouch solution for injection in pre-filled pen, Wegovy 0.5 mg FlexTouch solution for injection in pre-filled pen, Wegovy 2.4 mg FlexTouch solution for injection in pre-filled pen

Primary endpoint: Maintenance of BMI below obesity threshold. From 1.5 years to 3 years. Count of participant.
Endpoint(s): Maintenance of improved BMI category. From 1.5 years to 3 years and end of continued treatment phase (up to 6 years). Count of participant., Tapering to zero dose. From 1.5 years to 3 years. Count of participant., Time/dose steps before ending dose tapering. From 1.5 years to 3 years. Weeks, count of dose steps., Achieving BMI below obesity threshold. From baseline (day 0) to 1.5, 3 years and end of continued treatment phase (up to 6 years). Count of participant., Achieving any improvement in BMI category. From baseline (day 0) to 1.5, 3 years, and end of continued treatment phase (up to 6 years). Count of participant., Change in BMI. From baseline (day 0) to 1.5 and 3 years. Percent., BMI percentage of the 95th percentile. From baseline (day 0) to 1.5 and 3 years. Percent., Change in BMI SDS. From baseline (day 0) to 1.5 and 3 years. Unitless., Change in waist-to-height ratio (waist [cm]/ height [cm]). From baseline (day 0) to 1.5 and 3 years. Unitless., Change in waist circumference. From baseline (day 0) to 1.5 and 3 years. Cm., Change in HbA1c. From baseline (day 0) to 1.5, 3 years and end of continued treatment phase (up to 6 years). Percentage points., Change in fasting plasma glucose. From baseline (day 0) to 1.5, 3 years, and end of continued treatment phase (up to 6 years). mmol/L, mg/dL., Change in fasting insulin and HOMA-IR. From baseline (day 0) to 1.5, 3 years, and end of continued treatment phase (up to 6 years). Percent., Change in hsCRP. From baseline (day 0) to 1.5, 3 years, and end of continued treatment phase (up to 6 years). Percent., Change in ALT, total cholesterol, HDL, LDL, VLDL and triglycerides. From baseline (day 0) to 1.5, 3 years, and end of continued treatment phase (up to 6 years). Percent., Change in systolic and diastolic blood pressure. From baseline (day 0) to 1.5 and 3 years and end of continued treatment phase (up to 6 years). mmHg., Change in fat mass, by DXA relative to total body mass. From baseline (day 0) to 1.5 and 3 years. Percentage points., Change in lean body mass, by DXA relative to total body mass. From baseline (day 0) to 1.5 and 3 years. Percentage points., Relative change in visceral fat mass by DXA. From baseline (day 0) to 1.5 and 3 years. Percent., SAEs. From baseline (day 0) to 1.5 years, from 1.5 to 3 years, and from 3 years to end of continued treatment phase (up to 6 years). Count.

Source: https://euclinicaltrials.eu/ctis-public/view/2023-508055-40-00